EU clinical trial 2024-513811-29-00: Effect of early use of levosimendan versus placebo on top of a conventional strategy of inotrope use on a combined morbidity-mortality endpoint in patients with cardiogenic shock. LevoHeartShock
Protocol code: 2018/LEVOHEARTSHOCK
Sponsor: CHRU De Nancy (Hospital/Clinic/Other health care facility). Phase: Therapeutic confirmatory (Phase III). Countries: France (ongoing, recruiting).
Therapeutic area(s): Diseases [C] - Cardiovascular Diseases [C14]
Gender: Female, Male. Age: 18-64 years, 65+ years. Enrolment: 506.
Status: Ongoing, recruiting. Start date (EU): 2023-07-03. Decision date: 2024-08-01. Results received: No. Last updated: 2026-07-06.

Condition(s): Cardiogenic Shock
Product: ZIMINO 2,5 mg/ml, solution à diluer pour perfusion, SOLUVIT, lyophilisat pour usage parentéral, CERNEVIT, poudre pour solution injectable ou pour perfusion

Primary endpoint: All-cause mortality and/or ECLS and/or dialysis at day 30 following randomization.
Endpoint(s): Prioritized composite endpoint at days 90 with the following priority order: 1/ time to death, 2/ escalation to permanent left ventricular assist device or cardiac transplantation, 3/ dialysis, 4/ ECLS requirement, 5/ number of cardiovascular events (stroke, recurrent myocardial infarction, urgent coronary revascularization, re-hospitalization for heart failure)., Major adverse cardiovascular events: death, ECLS requirement, dialysis, cardiac transplantation, escalation to permanent left ventricular assist device, major cardiovascular events (stroke, recurrent myocardial infarction, urgent coronary revascularization, re-hospitalization for heart failure) on days 90, Composite endpoint of all-cause mortality and/or ECLS requirement and/or dialysis on day 90;, Number of dobutamine free days between randomization and D30, Number of vasopressors free days between randomization and D30;, Number of ventilatory free days between randomization and D30, Number of renal replacement free days between randomization and D 90, Lactate clearance from randomization to D7, Duration of ICU stay and hospitalization, Composite endpoint of all-cause mortality and/or ECLS requirement and/or dialysis on days 7, 60, and 180 days and 12 months following randomization, Number of renal replacement free days between randomization and D 30, 60, 180 and at 12 months, Major adverse cardiovascular events: death, ECLS requirement, dialysis, cardiac transplantation, escalation to permanent left ventricular assist device, major cardiovascular events (stroke, recurrent myocardial infarction, urgent coronary revascularization, re-hospitalization for heart failure) on days 180 and at 12 months;, Occurrence of arrhythmias requiring therapy with anti-arrhythmic drugs or electric cardioversion (including atrial fibrillation, ventricular tachycardia, ventricular fibrillation, torsade de pointe) from randomization to ICU or CCU discharge., Changes in biomarkers between randomization and ICU/CCU discharge, For objectives B2 and B3 the primary outcome will be considered

Source: https://euclinicaltrials.eu/ctis-public/view/2024-513811-29-00